EU clinical trial 2022-502828-42-00: A Two-Cohort, Phase II, Multicenter, Randomized, Double-Blind, Parallel-Group, Placebo-Controlled Study Evaluating the Efficacy and Safety of Vixarelimab Compared with Placebo in Patients with Idiopathic Pulmonary Fibrosis and in Patients with Systemic Sclerosis-Associated Interstitial Lung Disease
Protocol code: GB44496
Sponsor: Genentech Inc. (Pharmaceutical company). Phase: Therapeutic exploratory (Phase II). Countries: Germany (ended), Hungary (ended), Italy (ended), France (ended), Poland (ended), Belgium (ended), Greece (ended), Spain (ended).
Therapeutic area(s): Diseases [C] - Respiratory Tract Diseases [C08]; Diseases [C] - Immune System Diseases [C20]
Gender: Female, Male. Age: 18-64 years, 65+ years. Enrolment: 134.
Status: Ended. Start date (EU): 2023-09-01. End date (EU): 2025-12-18. End date: 2026-01-12. Decision date: 2023-08-01. Results received: No. Last updated: 2026-02-27.
Decision dates by country: ES: 2023-08-17, BE: 2023-08-01, PL: 2023-08-07, HU: 2023-08-04, GR: 2023-08-02, FR: 2023-08-07, DE: 2023-08-02, IT: 2023-08-04

Condition(s): Idiopathic Pulmonary Fibrosis, Systemic Sclerosis-Associated Interstitial Lung Disease
Product: Vixarelimab, Vixarelimab Placebo

Primary endpoint: 1. Absolute change from baseline to Week 52 in FVC (mL)
Endpoint(s): 1. Absolute change from baseline to Week 52 in 6MWT distance (in meters), 2. Absolute change from baseline to Week 52 in percentage of predicted FVC, 3. Change from baseline to Week 52 in DLCO [Hb], 4. Time to disease progression, defined as time to first occurrence of ≥10% absolute decline in percentage of predicted FVC, ≥15% relative decline in 6MWT distance, lung transplantation, or death, 5. Time to first acute exacerbation of ILD, or suspected acute exacerbation of ILD, as determined by the CAC, 6. Change from baseline to Week 52 in quantitative lung fibrosis on HRCT scan of the thorax, 7. Survival, as measured by all-cause mortality, 8. Cohort 2: Change from baseline to Week 52 in skin sclerosis, as measured by the modified Rodnan skin score (mRSS), 9. Change from baseline to Week 52 in health-related quality of life (HRQoL), as measured by the King’s Brief Interstitial Lung Disease (K-BILD) Questionnaire total score, 10. Change from baseline to Week 52 in cough, as measured by the Living with Pulmonary Fibrosis (L-PF) Symptoms cough domain score, 11. Change from baseline to Week 52 in dyspnea, as measured by the L-PF Symptoms dyspnea domain score, 12. Cohort 2: Change from baseline to Week 52 in pruritus, as measured by the 5-D Itch Scale total score, 13. Incidence and severity of adverse events, with severity determined according to the Division of AIDS (DAIDS) toxicity grading scale, 14. Change from baseline in targeted vital signs, 15. Change from baseline in targeted clinical laboratory test results, 16. Serum concentration of vixarelimab at specified timepoints, 17. Prevalence of anti-drug antibodies (ADAs) at baseline and incidence of ADAs during the study

Source: https://euclinicaltrials.eu/ctis-public/view/2022-502828-42-00